EU clinical trial 2023-508567-75-00: Prospective pilot study, assessing imaging performance of 89Zirconium-labelled Girentuximab (89Zr-TLX250) PET-CT in Patients with HepatoCellular Carcinoma, Biliary Tract Cancers or Gastro-Entero-Pancreatic Neuroendocrine Neoplasms.
Protocol code: RC23_0453
Sponsor: Centre Hospitalier Universitaire De Nantes (Hospital/Clinic/Other health care facility). Phase: Phase I and Phase II (Integrated)- Other. Countries: France (temporarily halted).
Therapeutic area(s): Diseases [C] - Digestive System Diseases [C06]
Gender: Female, Male. Age: 18-64 years, 65+ years. Enrolment: 60.
Status: Temporarily halted. Start date (EU): 2025-01-29. Decision date: 2024-11-27. Results received: No. Last updated: 2026-05-05.

Condition(s): Gastro-Entero-Pancreatic Neuroendocrine Neoplasms, HepatoCellular Carcinoma, Biliary Tract Cancer

Source: https://euclinicaltrials.eu/ctis-public/view/2023-508567-75-00